EU clinical trial 2024-511496-14-00: A Global Multicenter, Open Label, Randomized Phase 3 Registrational Study of Olverembatinib Combined with Chemotherapy Versus Investigator’s Choice of TKI Combined with Chemotherapy in Patients with Newly Diagnosed Philadelphia Chromosome-Positive Acute Lymphoblastic Leukemia (Ph+ ALL) (POLARIS-1)
Protocol code: HQP1351AG301
Sponsor: Ascentage Pharma Group Inc. (Pharmaceutical company). Phase: Therapeutic confirmatory (Phase III). Countries: Hungary (not authorised), France (ongoing, recruiting), Romania (authorised, recruitment pending), Czechia (authorised, recruitment pending), Italy (authorised, recruiting), Spain (ongoing, recruiting), Bulgaria (ended), Germany (authorised, recruitment pending), Greece (authorised, recruitment pending).
Therapeutic area(s): Diseases [C] - Neoplasms [C04]; Diseases [C] - Hemic and Lymphatic Diseases [C15]
Gender: Female, Male. Age: 18-64 years, 65+ years. Enrolment: 73.
Start date (EU): 2026-05-14. Decision date: 2025-07-01. Results received: No. Last updated: 2026-07-28.
Decision dates by country: HU: 2025-07-07, RO: 2025-07-07, IT: 2025-07-04, BG: 2025-07-07, CZ: 2025-07-04, FR: 2025-07-01, DE: 2026-07-27, GR: 2026-06-17, ES: 2025-07-02

Condition(s): Newly Diagnosed Philadelphia Chromosome-Positive Acute Lymphoblastic Leukemia (Ph+ ALL)
Product: METHOTREXATE, DEXAMETHASONE, DEXAMETHASONE, CYTARABINE, CYTARABINE, DASATINIB, PREDNISOLONE, CYTARABINE, PONATINIB, CYTARABINE, METHOTREXATE, METHOTREXATE, VINCRISTINE SULFATE, PREDNISOLONE, IMATINIB MESILATE, METHOTREXATE, DEXAMETHASONE, Olverembatinib, DEXAMETHASONE, VINCRISTINE SULFATE, DEXAMETHASONE, DASATINIB, DEXAMETHASONE

Primary endpoint: MRD-negative CR rate at the end of induction (EOI): MRD-negativity is defined as BCR-ABL/ABL1 ≤ 0.01% measured centrally by reverse transcription qPCR. CR is defined as meeting the following criteria: ①No circulating blasts; No extramedullary disease (i.e., no lymphadenopathy, splenomegaly, skin/gum infiltration, testicular mass or CNS involvement);, Normal maturation of all cellular components in the BM and less than 5% blasts in the bone marrow;, absolute neutrophil count (ANC) ≥ 1.0 × 109/L, platelet counts ≥ 100 × 109/L, no relapse within 4 weeks
Endpoint(s): Event‑free survival (EFS): EFS is the key secondary endpoint. EFS is defined as the time from study randomization to the date of treatment failure (ITF), relapse from CR, or death from any cause, whichever comes first. ITF is defined as failure to achieve CR during induction period (i.e., considering CRi responses treatment failures)., Overall response rate (ORR): ORR is defined as complete response (CR), CR with partial hematologic recovery (CRh) and CR with incomplete hematologic recovery (CRi). (1) CRh is defined as hematologic complete remission with partial hematologic recovery and meeting all criteria for CR except platelet count and ANC (ANC > 0.5 × 109/L and platelet counts > 50 × 109/L), CRi is defined as hematologic complete remission with incomplete hematologic recovery and meeting all criteria for CR except platelet count or ANC (platelet counts < 100 × 109/L and ANC ≥ 1.0 × 109/L, or platelet counts ≥ 100 × 109/L and ANC < 1.0 × 109/L), Duration of MRD-negative CR: The interval from the date when MRD-negative CR criteria are first met upon evaluation to the date of molecular relapse from MRD-negativity, or relapse after CR, or to the date of leukemia-related death., Duration of CR, CRh or CRi: The interval from the date when CR, CRh, or CRi criteria are first met upon evaluation to the earliest date of relapse after CR, CRh or CRi., Time to MRD-negative CR: The interval from the date of randomization to the date when MRD-negative CR first met upon evaluation, Time to CR, CRh or CRi: The interval from the date of randomization to the date when CR, CRh or CRi criteria are first met upon evaluation, Time to treatment failure: The time to discontinuation of randomized study treatment (excluding HSCT performed when MRD-negativity is maintained) for patients due to safety concerns and/or the loss of efficacy benefit, Progression‑free survival (PFS): PFS is defined as the date of randomization to the first documented occurrence of the following events: • Progressive disease: An increase of at least 25% in the absolute number of circulating or bone marrow blasts or development of extramedullary disease • Disease relapse: Reappearance of blasts in the blood or bone marrow (>5%) or in any extramedullary site after a CR/CRh/CRi • Death due to any cause, OS: The interval from the date of randomization to the date of death due to any cause (to the last contact date if the patient is still alive).

Source: https://euclinicaltrials.eu/ctis-public/view/2024-511496-14-00